EU clinical trial 2022-500107-50-00: Cholangiocarcinoma treatment with radiofrequency ablation or photodynamic therapy
Protocol code: CARP
Sponsor: University Of Leipzig. Phase: Therapeutic use (Phase IV). Countries: Germany (ongoing, recruiting).
Therapeutic area(s): Diseases [C] - Neoplasms [C04]; Diseases [C] - Digestive System Diseases [C06]
Gender: Female, Male. Age: 18-64 years, 65+ years. Enrolment: 258.
Status: Ongoing, recruiting. Start date (EU): 2022-10-12. Decision date: 2022-08-24. Results received: No. Last updated: 2025-06-16.

Condition(s): hilar cholangiocarcinoma
Product: Foscan 1 mg/ml solution for injection, PORFIMER SODIUM

Primary endpoint: The primary endpoint is overall survival, i.e. time from randomization to death from any cause or to the last known date on which the patient was alive. The comparison between arms will be based on the hazard ratio as estimated from a Cox regression model.
Endpoint(s): Overall survival (complementary perspectives), Days alive and out of hospital up to two years, Quality of Life (QoL) at various points in time after randomization (V2 (14 days), V3 (ca. 3 months), as a function of time after 6 months, adjusting for the baseline value), Quality-adjusted life years (QALYs), Stent patency based on clinician’s assessment (e.g. cholangitis, cholestasis, ultrasound), Laboratory parameters, Pruritus as a function of time up to two years will be considered

Source: https://euclinicaltrials.eu/ctis-public/view/2022-500107-50-00